EU clinical trial 2024-513770-22-00: A Phase 2, multicenter, randomized, open-label trial of GEN1046 as monotherapy and in combination with Pembrolizumab in subjects with relapsed/refractory metastatic non-small cell lung cancer after treatment with standard care therapy with a immune checkpoint inhibitor.
Protocol code: GCT1046-04
Sponsor: Genmab A/S (Pharmaceutical company). Phase: Therapeutic exploratory (Phase II). Countries: Spain (ended), Portugal (ended), Netherlands (ended), Germany (ended), France (ended), Italy (ongoing, recruitment ended), Poland (ended).
Therapeutic area(s): Diseases [C] - Neoplasms [C04]
Gender: Female, Male. Age: 18-64 years, 65+ years. Enrolment: 100.
Start date (EU): 2021-09-22. Decision date: 2024-09-19. Results received: No. Last updated: 2026-06-12.
Decision dates by country: FR: 2024-10-07, PL: 2024-10-28, ES: 2024-09-19, DE: 2024-09-25, NL: 2024-09-19, IT: 2024-11-04, PT: 2024-09-24

Condition(s): Malignant Solid Tumors - Non Small Cell Lung Cancer
Product: Acasunlimab, KEYTRUDA 25 mg/mL concentrate for solution for infusion

Primary endpoint: Objective response rate (ORR) per Response Evaluation Criteria in Solid Tumors (RECIST) v1.1 as assessed by investigator
Endpoint(s): Duration of response (DOR) per RECIST v1.1. -, Time to response (TTR) per RECIST v1.1., Progression-free survival (PFS) per RECIST v1.1, Overall survival (OS), Incidence and severity of adverse events (AEs), Incidence and severity of laboratory abnormalities

Source: https://euclinicaltrials.eu/ctis-public/view/2024-513770-22-00